EU clinical trial 2024-511236-27-00: A Phase Ib/ IIa, open-label, dose finding, safety, tolerability and exploratory study of THEO-260 in patients with high grade serous or endometrioid ovarian cancer
Protocol code: THEO-260-001
Sponsor: Theolytics Limited (Pharmaceutical company). Phase: Phase I and Phase II (Integrated)- First administration to humans. Countries: Spain (ongoing, recruiting).
Therapeutic area(s): Diseases [C] - Neoplasms [C04]
Gender: Female. Age: 18-64 years, 65+ years. Enrolment: 10.
Status: Ongoing, recruiting. Start date (EU): 2025-11-12. Decision date: 2025-07-16. Results received: No. Last updated: 2026-01-28.

Condition(s): High grade serous or endometroid ovarian cancer
Product: THEO-260

Primary endpoint: Part A: Safety and tolerability will be assessed by: 1) evaluation of DLTs and AEs (including but not limited to immunerelated AEs [irAEs]) during treatment and follow-up using NCI CTCAE v5.0 or American Society of Clinical Oncology (ASCO; for pneumonitis only) or American Society for Transplantation and Cellular Therapy (ASTCT; for CRS only). 2) Laboratory parameters. 3) Vital signs, physical examination, weight, 12-lead ECG and ECOG performance status, Part A: Evaluation of RP2D(s) using safety, tolerability, pharmacokinetics (PK), pharmacodynamics (PD) and if available, anti-tumour activity data by Response Evaluation Criteria in Solid Tumours (RECIST) v1.1., Part B: The response to RP2D dose(s) of THEO-260 will be assessed by ORR determined by tumour imaging according to RECIST v1.1.
Endpoint(s): Assess PK profile of THEO-260 in blood by qPCR., Assess shedding of THEO-260 in buccal, urine and faecal samples by qPCR., Assess systemic cytokine release following administration of THEO-260 by measurement of key markers in blood., Determine response to THEO-260 as assessed: 1) by tumour imaging according to RECIST v1.1 / iRECIST. 2) Changes in CA-125. 3) Quality of Life Questionnaires, Part B: Safety and tolerability will be assessed by: 1) evaluation of DLTs and AEs (including but not limited to irAEs) during treatment and follow-up using NCI CTCAE v5.0 or ASCO (for pneumonitis only) or ASTCT (for CRS only); 2) Laboratory parameters. 3) Vital signs, physical examination, weight, 12-lead ECG and ECOG performance status

Source: https://euclinicaltrials.eu/ctis-public/view/2024-511236-27-00